EU clinical trial 2024-520294-13-00: CITY
Protocol code: APHP240605
Sponsor: Assistance Publique Hopitaux De Paris (Hospital/Clinic/Other health care facility). Phase: Human Pharmacology (Phase I)- First administration to humans. Countries: Spain (authorised, recruitment pending), France (authorised, recruitment pending).
Therapeutic area(s): Diseases [C] - Skin and Connective Tissue Diseases [C17]
Gender: Female, Male. Age: 18-64 years, 65+ years. Enrolment: 35.
Status: Authorised, recruitment pending. Decision date: 2025-09-26. Results received: No. Last updated: 2026-03-04.
Decision dates by country: FR: 2025-09-26, ES: 2025-10-01

Condition(s): Cutaneous T-cell lymphomas (CTCL)

Source: https://euclinicaltrials.eu/ctis-public/view/2024-520294-13-00